EU clinical trial 2024-514740-82-00: Subcutaneous vedolizumab drug de-escalation in inflammatory bowel disease: a multicentre randomised controlled study
Protocol code: NL83430.172.01
Sponsor: Stichting Amsterdam UMC (Hospital/Clinic/Other health care facility). Phase: Therapeutic use (Phase IV). Countries: Netherlands (ongoing, recruiting).
Therapeutic area(s): Diseases [C] - Digestive System Diseases [C06]
Gender: Female, Male. Age: 18-64 years. Enrolment: 278.
Status: Ongoing, recruiting. Start date (EU): 2025-07-16. Decision date: 2025-03-20. Results received: No. Last updated: 2025-05-28.

Condition(s): Inflammatory Bowel Disease
Product: Entyvio 108 mg solution for injection in pre-filled syringe

Primary endpoint: Difference in relapse rate
Endpoint(s): Factors associated with successful interval extension, Proportion of patients having needed corticosteroïd treatment during follow-up, Differences in emergency visits, hospitalizations and surgery, Difference in quality of life, Cost-effectiveness of interval extension, Differences in adverse events, Vedolizumab pharmacodynamics and pharmacokinetics

Source: https://euclinicaltrials.eu/ctis-public/view/2024-514740-82-00